EU clinical trial 2022-502771-38-00: A study to learn how BAY2927088 is taken up and handled by the body in healthy male participants
Protocol code: 22249
Sponsor: Bayer AG (Pharmaceutical company). Phase: Human Pharmacology (Phase I)- Other. Countries: Netherlands (ended).
Therapeutic area(s): Diseases [C] - Neoplasms [C04]
Gender: Male. Age: 18-64 years. Enrolment: 8.
Status: Ended. Start date (EU): 2024-01-24. End date (EU): 2024-05-08. Decision date: 2023-10-04. Results received: No. Last updated: 2023-11-03.

Condition(s): Advanced non-small cell lung cancer with EGFR and/or HER2 mutations

Source: https://euclinicaltrials.eu/ctis-public/view/2022-502771-38-00